EU clinical trial 2023-509027-41-00: A study to investigate the safety and tolerability of dostarlimab in adult participants with chronic HBV infection on nucleos(t)ide analogue (NA) treatment
Protocol code: 222110
Sponsor: Glaxosmithkline Research & Development Limited (Pharmaceutical company). Phase: Human Pharmacology (Phase I)- Other. Countries: Bulgaria (ended), France (ended), Italy (ended), Spain (ended).
Therapeutic area(s): Diseases [C] - Virus Diseases [C02]
Gender: Female, Male. Age: 18-64 years. Enrolment: 23.
Status: Ended. End date (EU): 2024-12-02. End date: 2024-12-03. Decision date: 2024-11-11. Results received: No. Last updated: 2024-11-15.
Decision dates by country: BG: 2024-11-15, FR: 2024-11-12, IT: 2024-11-13, ES: 2024-11-11

Condition(s): Hepatitis B, Chronic

Source: https://euclinicaltrials.eu/ctis-public/view/2023-509027-41-00